EU clinical trial 2024-517410-15-01: Rectal preserving treatment for early rectal cancer. A multi-centred, partially randomised, patient-preference trial of radical surgery versus adjuvant chemoradiotherapy after local excision for early rectal cancer.
Sponsor: Amsterdam UMC Stichting (Hospital/Clinic/Other health care facility). Phase: Therapeutic confirmatory (Phase III). Countries: Netherlands (authorised, recruiting), France (authorised, recruiting).
Therapeutic area(s): Diseases [C] - Digestive System Diseases [C06]
Gender: Female, Male. Age: 18-64 years, 65+ years. Enrolment: 315.
Status: Authorised, recruiting. Start date (EU): 2025-01-14. Decision date: 2025-01-14. Results received: No. Last updated: 2025-01-29.
Decision dates by country: NL: 2025-01-14, FR: 2025-01-29

Condition(s): Rectal cancer
Product: Xeloda 150 mg film-coated tablets

Primary endpoint: Three-year local recurrence rate
Endpoint(s): Short-term morbidity: treatment related morbidity that occurs during treatment or within 30 days after the allocated treatment. The Comprehensive Classification index (see appendix) (36) and the NCI CTCAE Toxicity criteria will be used to assess to degree of morbidity in both separate treatment arms., Unsalvagable pelvic disease at three years, defined as locoregional recurrence that is not able to be treated with curative intent., Stoma rate at one, three and five year follow-up., Long-term morbidity: long-term morbidity such as surgical re-interventions and readmissions related to the primary intervention will be evaluated at one, three and five years., Functional outcome and HRQoL after therapy will be measured using the validated questionnaires EQ-5D, EORTC QLQ C29 & C30 and the LARS score for functional outcomes at admission and at 3, 6, 12, 24 and 36 months post-operatively., Health Economics; possible advantage of the new rectal preserving treatment in cost per quality of life adjusted life years using the EQ5D score will be analysed. The total costs will be assessed by summing the procedure related costs, in hospital stay costs, reintervention and morbidity related costs and time to return to work will be calculated in loss of work days, which can be converted to costs., Disease free and overall survival at three-year and five-year follow-up.

Source: https://euclinicaltrials.eu/ctis-public/view/2024-517410-15-01